EU clinical trial 2022-502180-38-00: An Open-label, Single Arm Study of the Safety, Pharmacokinetics, Pharmacodynamics, and Efficacy of Leniolisib in Pediatric Patients (Aged 1 to 6 Years) with APDS (Activated Phosphoinositide 3-Kinase Delta Syndrome) Followed by an Open-label Long-term Extension
Protocol code: LE 3302
Sponsor: Pharming Technologies B.V. (Pharmaceutical company). Phase: Therapeutic confirmatory (Phase III). Countries: Portugal (ended), Spain (ended).
Therapeutic area(s): Diseases [C] - Immune System Diseases [C20]
Gender: Female, Male. Age: 0-17 years. Enrolment: 4.
Status: Ended. Start date (EU): 2024-12-16. End date (EU): 2026-05-28. Decision date: 2024-08-06. Results received: No. Last updated: 2026-06-12.
Decision dates by country: ES: 2024-08-06, PT: 2024-08-08

Condition(s): Activated Phosphoinositide 3-Kinase Delta Syndrome
Product: CDZ173/Leniolisib, CDZ173/Leniolisib, CDZ173/Leniolisib

Primary endpoint: Incidence of treatment-emergent AEs (TEAEs), SAEs, and AEs leading to discontinuation of study drug, Change from baseline in clinical laboratory test results (hematology, blood chemistry, urinalysis), Change from baseline in vital signs, Change from baseline in physical examination findings, Change from baseline in electrocardiograms (ECGs), Сhange from baseline in growth and physical development, Reduction in lymphoproliferation as measured by MRI or low-dose CT at end of 12 weeks of treatment, Immunophenotype normalization assessed by changes from baseline in the proportion of naïve B cells among all B cells to end of 12 weeks of treatment., All safety parameters (including TEAEs, SAEs, AEs leading to discontinuation of study drug, physical exam, vital signs, ECGs, growth and physical development, and clinical laboratory results).
Endpoint(s): Population pharmacokinetics (popPK) model that describes the appropriate covariates (eg, body weight and age) that influence leniolisib plasma PK in pediatric patients (from baseline to end of 12 weeks of treatment), PK parameters, as appropriate, including but not limited to: - maximum observed plasma concentration (Cmax) - minimum observed plasma concentration (Cmin) - time to reach Cmax (Tmax) - area under the plasma concentration-time curve from time 0 over the dosing interval (AUC0-τ) - terminal elimination half-life (t1/2) - apparent oral clearance at steady-state concentration (CLss/F) - apparent oral volume of distribution at steady state concentration (Vss/F), Frequency of infections, use of antibiotics, and Ig replacement therapy, Reduction in lymphoproliferation as measured by MRI or low-dose CT at 1 year, as measured by SPD of index and measurable non-index lesions selected as per the Cheson methodology, 3D volume and 3D sizes of spleen and liver, where appropriate, Incidence of infections, use of antibiotics, and use of Ig replacement therapy

Source: https://euclinicaltrials.eu/ctis-public/view/2022-502180-38-00